EU clinical trial 2024-519204-27-00: A phase 2 study of trifluridine/tipiracil in patients with ER-positive, HER2-negative advanced breast cancer that previously received chemotherapy (BOOG 2019-01 TIBET study)
Protocol code: BOOG 2019-01
Sponsor: BOOG Study Center B.V. (Laboratory/Research/Testing facility). Phase: Therapeutic exploratory (Phase II). Countries: Netherlands (ended).
Therapeutic area(s): Diseases [C] - Neoplasms [C04]
Gender: Female. Age: 18-64 years, 65+ years. Enrolment: 50.
Status: Ended. Start date (EU): 2020-09-25. End date (EU): 2026-02-16. Decision date: 2024-11-15. Results received: Yes. Last updated: 2024-11-15.

Condition(s): Advanced breast cancer
Product: Lonsurf 20 mg/8.19 mg film-coated tablets, Lonsurf 15 mg/6.14 mg film-coated tablets

Primary endpoint: Percentage of patients being progression free at 8 weeks on trifluridine/tipiracil prescribed for ER-positive, HER2-negative advanced breast cancer patients previously treated with a taxane and capecitabine
Endpoint(s): Progression free survival, Response rate CR/PR at 16 weeks, Adverse Events, Quality of Life

Source: https://euclinicaltrials.eu/ctis-public/view/2024-519204-27-00